EU clinical trial 2023-505028-74-00: COLchicine in BElgium in patients with coronary artery disease after Percutaneous Coronary Intervention
Protocol code: COL BE PCI
Sponsor: Universitair Ziekenhuis Gent, Az St-Jan Brugge-Oostende A.V. (Hospital/Clinic/Other health care facility). Phase: Therapeutic confirmatory (Phase III). Countries: Belgium (ongoing, recruiting).
Therapeutic area(s): Diseases [C] - Cardiovascular Diseases [C14]
Gender: Female, Male. Age: 18-64 years, 65+ years. Enrolment: 2770.
Status: Ongoing, recruiting. Start date (EU): 2024-01-29. Decision date: 2023-09-11. Results received: No. Last updated: 2025-09-08.

Condition(s): Coronary artery disease
Product: Colchicine Tiofarma 500 microgram Tablets, Placebo Colchicine 0.5 mg tablets

Primary endpoint: The primary endpoint is time from randomisation to first occurrence of a composite endpoint consisting of: all-cause death, spontaneous (non-procedural) non-fatal myocardial infarction (Type 1, 4B & C), non-fatal stroke, or coronary revascularisation.
Endpoint(s): Time from randomisation to first occurrence of: ▪ a composite of specific cardiovascular endpoint consisting of: cardiovascular death, spontaneous (non-procedural) non-fatal myocardial infarction (Type 1, 4B & C), non-fatal stroke or coronary revascularisation ▪ a composite of hard endpoints consisting of: all-cause death, spontaneous (non-procedural) non-fatal myocardial infarction (Type 1, 4B & C), non-fatal stroke ▪ Breakdown components of primary endpoint and atherosclerosis-related diseases, Time from randomisation to occurrence of first as well as recurrent endpoints consisting of: all-cause death, spontaneous (non-procedural) non-fatal myocardial infarction (Type 1, 4B & C), non-fatal stroke, or coronary revascularisation., Change from randomisation to year 1 and to end of study of participants reported outcomes (based on ICHOM Standard Set for CAD) o Seattle Angina Questionnaire (SAQ) Angina Frequency Scale o Dyspnea (Rose Dyspnea Scale) o Depression (Patient Health Questionnaire PHQ-2)

Source: https://euclinicaltrials.eu/ctis-public/view/2023-505028-74-00